EU clinical trial 2024-512320-11-00: Age-adjusted high-dose chemotherapy followed by autologous stem cell transplantation or conventional chemotherapy with R-MP as first-line treatment in elderly primary CNS lymphoma patients – a randomized phase III trial - PRIMA-CNS
Protocol code: P003077
Sponsor: Medical Center - University Of Freiburg (Hospital/Clinic/Other health care facility). Phase: Therapeutic confirmatory (Phase III). Countries: Germany (ongoing, recruiting), Austria (ongoing, recruiting).
Therapeutic area(s): Diseases [C] - Hemic and Lymphatic Diseases [C15]
Gender: Female, Male. Age: 65+ years. Enrolment: 260.
Status: Ongoing, recruiting. Start date (EU): 2023-08-09. Decision date: 2024-08-16. Results received: No. Last updated: 2026-06-12.
Decision dates by country: AT: 2024-08-21, DE: 2024-08-16

Condition(s): Primary diffuse large B-cell lymphoma of the central nervous system (PCNSL) is a rare lymphoma affecting only the central nervous system compartment. PCNSL patients are typically 60 years or older and have poor prognoses. Considering the poor prognosis of this patient population, this randomised phase III trial proposal is of great clinical importance to provide patients optimal treatment.
Product: METHOTREXATE DISODIUM, CARMUSTINE, RITUXIMAB, BUSULFAN, THIOTEPA, CYTARABINE, PROCARBAZINE

Primary endpoint: Progression free survival
Endpoint(s): • Overall survival (OS) • Event free survival (EFS; defined as time from randomization to premature end of treatment (EOT) due to any reason, lymphoma progression or death, whichever occurs first) • Remission during and after induction treatment • Remission after maintenance: 6 months after RAII • Quality of life (QoL): EORTC QLQ-C30, EORTC QLQ-BN20; measured during screening period, at RAII and premature EOT visit and thereafter every 12 months during follow-up.

Source: https://euclinicaltrials.eu/ctis-public/view/2024-512320-11-00